EU clinical trial 2024-518856-21-00: A proof-of-concept phase 2a, double-blind, 2-arm trial to investigate efficacy and safety of twice daily delgocitinib cream 20 mg/g compared with cream vehicle during a 16-week treatment period in adult subjects with mild to severe palmoplantar pustulosis
Protocol code: LP0133-2393
Sponsor: Leo Pharma A/S (Pharmaceutical company). Phase: Therapeutic exploratory (Phase II). Countries: Germany (ongoing, recruiting), Poland (ongoing, recruiting).
Therapeutic area(s): Diseases [C] - Skin and Connective Tissue Diseases [C17]
Gender: Female, Male. Age: 18-64 years, 65+ years. Enrolment: 70.
Status: Ongoing, recruiting. Start date (EU): 2025-08-28. Decision date: 2025-08-01. Results received: No. Last updated: 2026-07-07.
Decision dates by country: DE: 2025-08-01, PL: 2025-08-18

Condition(s): Mild to severe palmoplantar pustulosis
Product: Cream Vehicle, Delgocitinib cream

Primary endpoint: PPPASI-75 at Week 16
Endpoint(s): PPP-PGA score of 0 or 1 (clear or almost clear) with at least a 2-step improvement from baseline at Week 16., Change in overall number of fresh pustules from baseline to Week 16.

Source: https://euclinicaltrials.eu/ctis-public/view/2024-518856-21-00